EU clinical trial 2023-504691-18-00: Efficacy of EMONO as an add-on therapy to conventional antidepressants for the treatment of depressive symptoms in nursing-home residents with neurocognitive disorders: a randomized controlled trial
Protocol code: DR220204
Sponsor: Centre Hospitalier Regional Universitaire De Tours (Hospital/Clinic/Other health care facility). Phase: Therapeutic exploratory (Phase II). Countries: France (authorised, recruiting).
Therapeutic area(s): Psychiatry and Psychology [F] - Mental Disorders [F03]
Gender: Female, Male. Age: 65+ years. Enrolment: 96.
Status: Authorised, recruiting. Start date (EU): 2026-05-01. Decision date: 2024-04-03. Results received: No. Last updated: 2026-06-12.

Condition(s): psychiatry
Product: Medical Air, KALINOX 50%/50%, gaz medicinal comprime

Primary endpoint: Changes in the CORNELL depression severitý scale between S4 (one week after the last administration of MEOPA or medical air) and S1 (baseline).
Endpoint(s): CORNELL scale and GDS scale at weeks 1, 2, 3, 4 and 8, CGI-S and CGI-I scales at weeks 1, 2, 3, 4 and 8, The NPI scale for the frequency and severitý of the 12 most frequent psychobehavioural disorders in TNC at weeks 1, 4 and 8., The measurement of well-being by the EVIBE visual analogue scale at weeks 1, 2, 3, 4, and 8., Collection of adverse events at all study visits.

Source: https://euclinicaltrials.eu/ctis-public/view/2023-504691-18-00